EU clinical trial 2023-509425-53-00: An Open-Label Extension Study to Assess the Long-Term Safety and Efficacy of Dupilumab in Patients ≥6 Months to <18 Years of Age With Atopic Dermatitis.
Protocol code: R668-AD-1434
Sponsor: Regeneron Pharmaceuticals Inc. (Pharmaceutical company). Phase: Therapeutic confirmatory (Phase III). Countries: Poland (ongoing, recruitment ended), Germany (ended), Czechia (ended).
Therapeutic area(s): Diseases [C] - Skin and Connective Tissue Diseases [C17]
Gender: Female, Male. Age: 0-17 years. Enrolment: 201.
Start date (EU): 2015-11-09. Decision date: 2024-09-30. Results received: No. Last updated: 2025-11-04.
Decision dates by country: CZ: 2024-10-01, DE: 2024-09-30, PL: 2024-09-30

Condition(s): Atopic Dermatitis
Product: Dupixent 200 mg solution for injection in pre-filled syringe, Dupixent 300 mg solution for injection in pre-filled pen, Dupixent 300 mg solution for injection in pre-filled syringe, Dupixent 200 mg solution for injection in pre-filled pen

Primary endpoint: Rate of treatment-emergent adverse events (TEAEs) per participant year from baseline through the last study visit, Number of participants with at least one TEAE per participant year from baseline through the last study visit, OPTIONAL SUB-STUDY: Pharmacokinetic (PK) of dupilumab: Peak concentration (Cmax), OPTIONAL SUB-STUDY: PK of dupilumab: Trough concentration (Ctrough), OPTIONAL SUB-STUDY: Incidence of TEAEs during the 12-week PFP treatment period and during entire sub-study, OPTIONAL SUB-STUDY: Incidence of SAEs during the 12-week PFP treatment period and during entire sub-study
Endpoint(s): Number of treatment-emergent serious adverse events (SAEs) from baseline through the last study visit, Incidence of TEAEs of special interest from baseline through the last study visit, Proportion of participants with an Investigator Global Assessment (IGA) score of 0 or 1 (clear or almost clear) at all in-clinic visits post-baseline, Proportion of participants with Eczema Area and Severity Index (EASI)-75 (≥75% reduction in EASI from baseline of parent study) response at all in-clinic visits post-baseline, Change from baseline in EASI score at all in-clinic visits post-baseline, Percent change from baseline in EASI at all in-clinic visits post-baseline, Change from baseline in Body Surface Area (BSA) affected by AD (BSA) at all in-clinic visits post-baseline, Percent change from baseline in SCORing Atopic Dermatitis (SCORAD) at all in-clinic visits post-baseline, Change from baseline in Children’s Dermatology Life Quality Index (CDLQI) for participants ≥4 years of age at all in-clinic visits post-baseline in which the assessments are planned to be performed, Change from baseline in Infants’ Dermatology Quality of Life Index (IDQOL) for participants <4 years of age at all in-clinic visits post-baseline in which the assessments are planned to be performed, Proportion of responders (defined as participants with IGA 0 or 1) who maintain IGA 0 or 1 during at least 75% of the subsequent visits during the treatment period, For responders (defined as participants with IGA 0 or 1), median percentage of subsequent visits during the treatment period, at which IGA 0 or 1 is maintained, Number of AD flares during the study, Annualize event rate of AD flares during the study, Proportion of participants with at least one flare during the study, Proportion of well-controlled weeks, OPTIONAL SUB-STUDY: Incidence and titer of treatment-emergent anti-drug antibodies (ADA) (PFP Sub-Study)

Source: https://euclinicaltrials.eu/ctis-public/view/2023-509425-53-00